EU clinical trial 2024-517345-14-00: ZAMBA: Zoledronic Acid for Modic Back Pain. A randomized, double blind, placebo-controlled, multicenter trial
Protocol code: ZAMBA
Sponsor: Oslo University Hospital HF (Hospital/Clinic/Other health care facility). Phase: Therapeutic confirmatory (Phase III). Countries: Norway (authorised, recruitment pending).
Therapeutic area(s): Diseases [C] - Musculoskeletal Diseases [C05]
Gender: Female, Male. Age: 18-64 years. Enrolment: 118.
Status: Authorised, recruitment pending. Decision date: 2025-01-22. Results received: No. Last updated: 2025-10-30.

Condition(s): Low Back Pain
Product: NaCl 0,9 % B. Braun, solution pour perfusion, Aclasta 5 mg solution for infusion

Primary endpoint: Change from baseline at one year in mean Oswestry Disability Index (ODI)-score
Endpoint(s): Change from baseline at one year in mean LBP intensity (three NRS scales), Change from baseline at one year in Roland Morris Disability Questionnaire (RMDQ) score, Change from baseline at one year in EQ-5D, Concomitant treatments (pharm. and non-pharmacological) used between baseline and one-year follow-up, Global perceived effect at one year follow-up

Source: https://euclinicaltrials.eu/ctis-public/view/2024-517345-14-00